EU clinical trial 2023-510561-10-00: Antioxidant Treatment with Vitamin C in Cardiac Surgery Patients – A Pilot Randomized Controlled Trial
Protocol code: The ACCURATE Study
Sponsor: GCP-Service International West GmbH (Pharmaceutical company). Phase: Therapeutic exploratory (Phase II). Countries: Germany (ended).
Therapeutic area(s): Diseases [C] - Cardiovascular Diseases [C14]
Gender: Female, Male. Age: 18-64 years, 65+ years. Enrolment: 60.
Status: Ended. Start date (EU): 2024-07-19. End date (EU): 2026-06-10. Decision date: 2024-05-28. Results received: No. Last updated: 2025-05-28.

Condition(s): Cardiovascular illness, Intensive care unit (ICU), open-heart surgery
Product: Pascorbin® Wirkstoff: Ascorbinsäure 150 mg pro ml Injektionslösung

Primary endpoint: The area under the curve of serum levels of IL-6 from baseline to 72 hours after surgery
Endpoint(s): 30 day and 6-month all-cause mortality, Days alive and out of hospital, Time to discharge alive (TDA), Persistent organ dysfunction and death, ICU and hospital length of stay, ICU and hospital readmission rates, Area under the curve (AUC) of inflammatory markers (IL-1b, TNF-α and IFN-γ), Absolute values of daily measurements of C Reactive Protein (CRP), procalcitonin (PCT) and leukocytes during ICU stay, Daily overall Sequential Organ Failure Assessment (SOFA) Score, Duration and type (invasive or non-invasive) of mechanical ventilation, Duration and dosage of sedative agents used postoperatively, Occurrence of malignant arrhythmias, Occurrence of atrial fibrillation, Left ventricular ejection fraction (LVEF), New York Heart Association (NYHA) Classification, Number of cerebral ischemic or hemorrhagic events, Clinical Frailty Scale (CFS), Daily Confusion Assessment Method for the ICU (CAM-ICU) Score, Urine output during the ICU length of stay, Number of post operative complications including surgical re-evaluation, severe hemorrhage requiring surgical intervention, thromboembolic events requiring intervention, infection and sepsis, Adverse Events leading to discontinuation/Adverse Events at least possibly related to the IMP/Serious Adverse Events and Adverse Events of Special Interest, Entzündungsmarker, die mit Point-of-Care-Methoden am Krankenbett analysiert werden (z. B. IL-1, IL-6, IL-8, IL-10, TNF-α, IFN-γ, CRP, PCT, D-Dimer, Ferritin)

Source: https://euclinicaltrials.eu/ctis-public/view/2023-510561-10-00